EU clinical trial 2022-501458-13-01: Pembro-FLASH - Phase II trial of Pembrolizumab in First-Line Treatment of Advanced-Stage Classic Hodgkin Lymphoma
Protocol code: Uni-Koeln-4938
Sponsor: University Of Cologne (Educational Institution). Phase: Therapeutic exploratory (Phase II). Countries: Germany (ongoing, recruiting).
Therapeutic area(s): Diseases [C] - Neoplasms [C04]
Gender: Female, Male. Age: 18-64 years. Enrolment: 40.
Status: Ongoing, recruiting. Start date (EU): 2026-04-29. Decision date: 2025-09-30. Results received: No. Last updated: 2026-03-12.

Condition(s): Advanced Stage of Classic Hodgkin Lymphoma
Product: CYCLOPHOSPHAMIDE, DOXORUBICIN, DACARBAZINE CITRATE, ETOPOSIDE, ADCETRIS 50 mg powder for concentrate for solution for infusion., DEXAMETHASONE, KEYTRUDA 25 mg/mL concentrate for solution for infusion

Primary endpoint: 1-year PFS estimate
Endpoint(s): Adverse events, Target number of P-BrECADD cycles per 100 participants, Remission status after 1x P (PET-1), 1x P + 2x P-BrECADD (PET-3) and after completion of PET-guided chemo-immunotherapy (PET-5 or PET-7, respectively), Overall survival after one year, Patient-reported outcomes (PRO-CTCAE, Fatigue, QLQ-C30 and Quality of Life)

Source: https://euclinicaltrials.eu/ctis-public/view/2022-501458-13-01